EU clinical trial 2024-513920-40-00: VshoRT-R3: Phase 1/2 study of valproic acid and short-course radiotherapy plus capecitabine as preoperatIve treatment in low-moderate risk rectal cancer
Sponsor: IRCCS Istituto Nazionale Tumori Fondazione Pascale (Hospital/Clinic/Other health care facility). Phase: Phase I and Phase II (Integrated)- Other. Countries: Italy (ongoing, recruiting).
Therapeutic area(s): Diseases [C] - Neoplasms [C04]
Gender: Female, Male. Age: 18-64 years, 65+ years. Enrolment: 120.
Status: Ongoing, recruiting. Start date (EU): 2013-01-11. Decision date: 2024-06-17. Results received: No. Last updated: 2025-11-24.

Condition(s): low- risk rectal cancel
Product: CAPECITABINE, VALPROIC ACID

Primary endpoint: Fase 1 : MTD capecitabina MTD capecitabina + acido valproico Fase 2: tasso di TRG1
Endpoint(s): Local control, disease free survival and overall survival. • Pathological CRM negative (margin >1 mm) and lymph node negative rate • Short and long-term toxicity • Surgical Complications • Quality of Life

Source: https://euclinicaltrials.eu/ctis-public/view/2024-513920-40-00